EU clinical trial 2024-513480-37-00: Bioequivalence of Calcifediol monohydrate 0.266 mg Soft Capsules in Healthy Participants Under Fasting Conditions.
Protocol code: CFA-1037-1-24
Sponsor: Laboratorios Cinfa S.A. (Pharmaceutical company). Phase: Human Pharmacology (Phase I)- Bioequivalence Study. Countries: Portugal (ended).
Therapeutic area(s): Not possible to specify
Gender: Female, Male. Age: 18-64 years. Enrolment: 60.
Status: Ended. Start date (EU): 2025-01-28. End date (EU): 2025-06-17. Decision date: 2024-12-20. Results received: No. Last updated: 2025-07-01.

Condition(s): No medical condition.

Source: https://euclinicaltrials.eu/ctis-public/view/2024-513480-37-00